EU clinical trial 2024-514504-13-00: A Phase 2, open-label, imaging study to explore the effects of sonelokimab in patients with active psoriatic arthritis or axial spondyloarthritis
Protocol code: M1095-snSpA-202
Sponsor: MoonLake Immunotherapeutics AG (Pharmaceutical company). Phase: Therapeutic exploratory (Phase II). Countries: Germany (ongoing, recruiting).
Therapeutic area(s): Diseases [C] - Musculoskeletal Diseases [C05]
Gender: Female, Male. Age: 18-64 years, 65+ years. Enrolment: 30.
Status: Ongoing, recruiting. Start date (EU): 2025-09-23. Decision date: 2025-03-18. Results received: No. Last updated: 2026-04-13.

Condition(s): psoriatic arthritis, axial spondyloarthritis
Product: 68Ga-FAPI-46, Sonelokimab

Primary endpoint: Change from baseline in 68Ga-FAPI SUVmax signal per lesion at Week 12, as detected by FAPI-PET/low-dose CT 46 scan, overall and per indication.
Endpoint(s): Change from baseline in 68Ga-FAPI SUVmean signal at Week 12, as detected by FAPI-PET/low-dose CT scan, overall and per indication., PsA only: Change from baseline in psoriatic arthritis magnetic resonance imaging scoring system (PsAMRIS) or global OMERACT EULAR ultrasound synovitis score (GLOESS) at Week 12., PsA only: Proportion of participants with PsAMRIS or GLOESS change at Week 12., PsA only: Proportion of participants who achieve American college of rheumatology (ACR)20, ACR50 and ACR70 at Week 12., PsA only: Proportion of participants who achieve ACR20, ACR50, ACR70, and ACR90 responses over 12 weeks (except Week 12 for ACR20, ACR50 and ACR70)., PsA only: Change from baseline in disease activity in psoriatic arthritis (DAPSA) score over 12 weeks., PsA only: Change from baseline in psoriatic arthritis disease activity score (PASDAS) score over 12 weeks., PsA only: Proportion of participants with PASDAS categories (remission; low, moderate, and high disease activity) over 12 weeks., PsA only: Change from baseline in disease activity score 28 using C-reactive protein (DAS28-CRP) score over 12 weeks., PsA only: Change from baseline in Psoriatic Arthritis Response Criteria (PsARC) score over 12 weeks., PsA only: Proportion of participants achieving minimal disease activity (MDA) at Week 12., PsA only: Proportion of participants achieving very low disease activity (VLDA) at Week 12., PsA only: Change from baseline in physician global assessment of disease activity (PhGADA) score over 12 weeks., PsA only: Change from baseline in Bath ankylosing spondylitis disease activity index (BASDAI) score over 12 weeks., PsA only: Change from baseline in 66 swollen joint count and 68 tender joint count (SJC66/TJC68) over 12 weeks., PsA only: Percentage change from baseline in psoriasis area severity index (PASI) score over 12 weeks., PsA only: Proportion of participants achieving PASI 50, PASI 75, PASI 90, and PASI 100 responses over 12 weeks., PsA only: Change from baseline in modified nail psoriasis severity index (mNAPSI) score over 12 weeks., PsA only: Change from baseline in health assessment questionnaire - disability index (HAQ-DI) score over 12 weeks., PsA only: Change from baseline in Leeds enthesitis index (LEI) enthesitis score over 12 weeks., PsA only: Proportion of participants enthesitis-free according to LEI over 12 weeks., PsA only: Change from baseline in Spondyloarthritis Research Consortium of Canada (SPARCC) enthesitis index over 12 weeks., PsA only: Proportion of participants enthesitis-free based on the SPARCC enthesitis score over 12 weeks., PsA only: Change from baseline in Maastricht ankylosing spondylitis enthesitis score (MASES) over 12 weeks., PsA only: Change from baseline in Leeds dactylitis index (LDI) over 12 weeks., PsA only: Proportion of participants dactylitis-free according to LDI over 12 weeks., PsA only: Change from baseline over 12 weeks in: - Patient global assessment of disease activity (PtGADA) - Patient’s assessment of arthritis pain (PtAAP) - Psoriatic assessment impact of disease (PsAID-12) - Functional assessment of chronic illness therapy (FACIT)-Fatigue - Short form-36 (SF-36) v2 - Work productivity and activity impairment (WPAI) questionnaire for specific health problem (WPAI:PsA) - Psoriatic Arthritis Quality of Life (PsAQoL)., Incidence, seriousness, relatedness, and severity of adverse events (AEs) and treatment-emergent adverse events (TEAEs) over 16 weeks., AEs / TEAEs leading to study withdrawal over 16 weeks., Adverse events of special interest (AESIs) over 16 weeks., Abnormal laboratory parameters (hematology, clinical chemistry, urinalysis) over 16 weeks., PK of sonelokimab (trough levels)., Antidrug antibodies, Change in exploratory biomarker levels before and after treatment., axSpA only: Change from baseline in the number of SIJ quadrants and vertebral corners with [68Ga]-FAPI uptake at Week 12, as detected by FAPI-PET/low-dose CT scan., axSpA only: Change from baseline in SPARCC MRI score in SIJ and spine (separately)., axSpA only: Proportion of participants with a decrease, no change or increase from baseline in SPARCC MRI score at Week 12 in SIJ and spine (separately)., axSpA only: Change from baseline in sacroiliac joint structural score (SSS) at Week 12., axSpA only: Proportion of participants with a decrease, no change or increase from baseline in SSS score at Week 12., axSpA only: Change from baseline in ankylosing spondylitis disease activity score (ASDAS)- C-Reactive Protein (CRP) over Week 12., axSpA only: Proportion of participants with ASDAS-CRP status (inactive disease, moderate, high, and very high disease activity) over 12 weeks., axSpA only: Proportion of participants who achieve ASDAS-CRP clinically important improvement (≥ 1.1 units) at Week 12., axSpA only: Proportion of participants who achieve assessment of spondyloarthritis international society (ASAS)20 and ASAS40 responses at Week 12., axSpA only: Change from baseline in BASDAI score over 12 weeks., axSpA only: Change from baseline in SJC66/TJC68 over 12 weeks., axSpA only: Change from baseline in Bath ankylosing spondylitis functional index (BASFI) score over 12 weeks., axSpA only: Change from baseline in MASES over 12 weeks., axSpA only: Change from baseline over 12 weeks in PtGADA.

Source: https://euclinicaltrials.eu/ctis-public/view/2024-514504-13-00